EU clinical trial 2022-503066-74-00: Phase 1/2a Open-Label, Dose-Escalation, Multicenter, First in-Human, Consecutive-Cohort, Clinical Trial of BI 1910, a Monoclonal Antibody to Tumor Necrosis Factor Receptor 2 (TNFR2), as a Single Agent and in Combination with Pembrolizumab in Subjects with Advanced Solid Tumors
Protocol code: 22-BI-1910-01
Sponsor: Bioinvent International AB (Pharmaceutical company). Phase: Phase I and Phase II (Integrated)- First administration to humans. Countries: Denmark (ended), Poland (ended), Spain (ended), Sweden (ended), Germany (ended).
Therapeutic area(s): Diseases [C] - Neoplasms [C04]
Gender: Female, Male. Age: 18-64 years, 65+ years. Enrolment: 186.
Status: Ended. Start date (EU): 2023-12-04. End date (EU): 2025-12-17. End date: 2025-12-18. Decision date: 2023-11-14. Results received: No. Last updated: 2025-10-07.
Decision dates by country: ES: 2023-11-14, PL: 2023-11-15, SE: 2023-11-14, DE: 2023-11-17, DK: 2023-11-14

Condition(s): Advanced solid tumors
Product: BI-1910, DEXAMETHASONE, KEYTRUDA 25 mg/mL concentrate for solution for infusion, DESLORATADINE, PARACETAMOL, PARACETAMOL, DIPHENHYDRAMINE HYDROCHLORIDE, CLEMASTINE, HYDROCORTISONE, DIPHENHYDRAMINE

Primary endpoint: Phases 1 and 2a: -Occurrence of adverse events (AEs) or serious adverse events (SAEs). -Changes from baseline in laboratory parameters, vital signs, and physical findings. - Frequency of dose interruptions and dose reductions. -Frequency of AEs leading to discontinuation of study treatment(s)., Phase 1: Occurrence of dose limiting toxicities (DLTs)., Phase 2a: Identification of dose/dose range fulfilling favorable pharmacokinetic (PK) and pharmacodynamic profile, with acceptable safety (based on the totality of the efficacy, safety, PK, and pharmacodynamic endpoint
Endpoint(s): Phases 1 and 2a: -Calculated standard PK parameters for BI 1910 (including, but not limited to, area under the serum concentration-time curve [AUC], maximum concentration [Cmax], and terminal half-life [t½]). -Incidence and titer of antidrug antibodies (ADAs)., Phase 1: RDR is defined as the range between MRAD and the MTD/MAD. MRAD is the lowest dose level at which at least 2 subjects experience ≥10% tumor shrinkage and/or relevant PK/PD parameters indicate biological activity: - Response based on RECIST 1:1 and iRECIST. - PK parameters AUC, Cmax, t½. - PD biomarkers such as TNFR2 receptor occupancy immune activation parameters, sTNFR2 and cytokine profiles, Phase 2a: - Objective response rate (ORR). - Duration of response (DoR).

Source: https://euclinicaltrials.eu/ctis-public/view/2022-503066-74-00